EU clinical trial 2024-515431-30-00: Interest of early erectile rehabilitation with Sildenafil after proctectomy for rectal cancer : Randomized controlled trial (RECTIL)
Protocol code: 2019/0398/HP
Sponsor: Centre Hospitalier Universitaire Rouen (Hospital/Clinic/Other health care facility). Phase: Therapeutic confirmatory (Phase III). Countries: France (ongoing, recruiting).
Therapeutic area(s): Diseases [C] - Male Urogenital Diseases [C12]
Gender: Male. Age: 18-64 years, 65+ years. Enrolment: 188.
Status: Ongoing, recruiting. Start date (EU): 2025-08-14. Decision date: 2024-09-03. Results received: No. Last updated: 2025-12-19.

Condition(s): Men treated with proctectomy for rectal cancer
Product: SILDENAFIL EG 50 mg, comprimé pelliculé, Placebo de Sildenafil EG 50mg, comprimé pelliculé

Primary endpoint: Patient response at 12 months post-operatively. A patient is defined as a responder by a score of at least 22 on the erectile function domain of the International Index of Erectile Function (IIEF), which includes the six questions of the IIEF related to erection (Q1-Q5 and Q15)
Endpoint(s): IIEF erectile function domain score combining the six IIEF questions related to erection (Q1-Q5 and Q15) measured at surgery, D0, M3, M6 and M9 postoperative, International Index of Erectile Function global score measured at surgery, D0, M3, M6, M9 and M12 postoperative, Quality of life score (EORTC QLQ - C30 and QLQ - CR29) measured at surgery, D0, M3, M6, M9 and M12 postoperative, LARS score measured at surgery, D0, M3, M6, M9 and M12 postoperative, Fecal Continence Score (Wexner score) measured at surgery, D0, M3, M6, M9 and M12 postoperative, The number of patients presenting spontaneous erections under treatment at M3, M6, M9 postoperative and without treatment at D0, and M12 postoperative., The number of patients with or without regular psychological followup. A patient is defined as having regular follow-up if he visits a psychologist and/or psychiatrist once or twice a month, Number of unused tablets during the study. The patient will be considered as non-compliant if tablet intake over the entire 10 months of treatment is < 80%., The number of AEs and SAEs in each group at D0, M3, M6, M9 and M12 postoperative

Source: https://euclinicaltrials.eu/ctis-public/view/2024-515431-30-00